EU clinical trial 2024-512752-38-00: A prospective randomized, double-blind, placebo-controlled, multi-center phase III study to evaluate the efficacy and safety of mocravimod as an adjunctive and maintenance treatment in adult in acute myeloid leukemia (AML) patients undergoing allogeneic hematopoietic cell transplantation (HCT)
Protocol code: PKRPC001
Sponsor: Priothera S.A.S. (Pharmaceutical company). Phase: Therapeutic confirmatory (Phase III). Countries: Germany (ongoing, recruiting), Spain (ongoing, recruiting), Italy (ongoing, recruiting), Poland (ongoing, recruiting), Romania (ongoing, recruiting), France (ongoing, recruiting).
Therapeutic area(s): Diseases [C] - Hemic and Lymphatic Diseases [C15]
Gender: Female, Male. Age: 18-64 years, 65+ years. Enrolment: 138.
Status: Ongoing, recruiting. Start date (EU): 2025-09-09. Decision date: 2024-08-08. Results received: No. Last updated: 2026-07-07.
Decision dates by country: RO: 2024-09-12, PL: 2024-08-08, IT: 2024-08-12, FR: 2024-08-08, DE: 2024-08-14, ES: 2024-08-12

Condition(s): Adjunctive and maintenance treatment to HCT
Product: Hard capsules containing maize starch, microcrystalline cellulose, magnesium stearate, Mocravimod (KRP203)

Primary endpoint: Relapse-free survival (RFS)
Endpoint(s): Overall Survival (OS) - mocravimod's effect on OS to that to placebo, RFS at EOS (End-of-study) - to assess the sustained efficacy of moc in comparison to placebo, Survival free from Grade III/IV aGvHD at 12 mo & time to acute GvHD, Survival free from moderate /severe cGvHD at EOS & time to cGvHD, GRFS (GvHD-free, Relapse-free survival at 12 mo and at EOS)

Source: https://euclinicaltrials.eu/ctis-public/view/2024-512752-38-00